EU clinical trial 2025-521206-18-00: A phase III, randomized, double-blind study assessing the efficacy and safety of intravenous lidocaine versus placebo in patients receiving intrathecal morphine analgesia in major digestive or abdominal surgery by laparotomy
Protocol code: LIDORACHI
Sponsor: GCS Ramsay Sante Enseignement Et Recherche (Laboratory/Research/Testing facility). Phase: Therapeutic confirmatory (Phase III). Countries: France (authorised, recruiting).
Therapeutic area(s): Diseases [C] - Digestive System Diseases [C06]
Gender: Female, Male. Age: 18-64 years, 65+ years. Enrolment: 76.
Status: Authorised, recruiting. Start date (EU): 2026-08-03. Decision date: 2025-06-27. Results received: No. Last updated: 2025-06-27.

Condition(s): Major patients receiving morphine spinal anaesthesia for major gastrointestinal or abdominal surgery by scheduled laparotomy.
Product: LIDOCAÏNE KABI 20 mg/mL, solution injectable, SODIUM CHLORIDE

Primary endpoint: Total consumption of morphine received postoperatively from the post-interventional monitoring room to H48 (in mg) in IV by PCA (Patient Controlled Analgesia), and oral dose converted to equivalent IV morphine where appropriate
Endpoint(s): Maximum score of the verbal numerical scale (scored from 0 to 10) at rest and during exertion (cough/mobilisation) over the last 12, 24, 48, 72 and 96 hours. The verbal numerical scale was collected every 4 hours after the end of the intervention until H96, Time between the end of the operation and the first gas described by the patient (in hours), Total consumption of IV morphine at H12, H24, H72 and H96 in the 2 groups, Time of first rise in the 2 groups, Duration of surgery (in minutes), defined as the time from incision to closure, Length of hospital stay (in days), Morphine-related adverse events by investigator (H0, H12, H24, H48, H72 and H96), Lidocaine-related adverse events by investigator (H0 and H12), Collection of adverse events in the 2 groups

Source: https://euclinicaltrials.eu/ctis-public/view/2025-521206-18-00